EU clinical trial 2022-501857-35-00: Psilocybin-assisted psychotherapy in the treatment of patients hospitalized for treatment-resistant depression: an open-label feasibility study with an experiential and systemic focus
Protocol code: PsiHos-D
Sponsor: Universitair Ziekenhuis Gent (Hospital/Clinic/Other health care facility). Phase: Therapeutic exploratory (Phase II). Countries: Belgium (ongoing, recruiting).
Therapeutic area(s): Diseases [C] - Nervous System Diseases [C10]; Psychiatry and Psychology [F] - Psychological Phenomena [F02]; Psychiatry and Psychology [F] - Behavior and Behavior Mechanisms [F01]; Psychiatry and Psychology [F] - Mental Disorders [F03]
Gender: Female, Male. Age: 18-64 years, 65+ years. Enrolment: 180.
Status: Ongoing, recruiting. Start date (EU): 2024-04-22. Decision date: 2023-09-26. Results received: No. Last updated: 2025-08-26.

Condition(s): treatment-resistant depression
Product: PEX010 Psilocybin

Primary endpoint: The safety of performing psilocybin-assisted psychotherapy in TRD in a hospitalized setting (reported Serious Adverse Events (SAEs) and changes in vital signs and suicidal ideation/behavior (measured using the Columbia Suicide Severity Rating Scale (C-SSRS)) for the duration of the hospitalization phase (until 3 weeks after the last psilocybin session)).
Endpoint(s): The feasibility of performing psilocybin-assisted psychotherapy in TRD in a hospitalized setting at 3 weeks after the last psilocybin session (recruitment and retention rates, acceptability of the intervention and procedures for the subjects as assessed through semi-structured interviews)., Reported AEs and changes in suicidal ideation/behavior (measured using the C-SSRS) until 12 weeks after the last psilocybin session., Remission of depressive symptoms (Quick Inventory of Depressive Symptomatology – Self Report (QIDS-SR) ≤5, Montgomery Asberg Depression Rating Scale (MADRS) ≤6) and improvement on the State-Trait Anxiety Inventory (STAI), World Health Organization Quality of Life Questionnaire (WHOQOL-BREF) and Maudsley 3-item Visual Analogue Scale (M3VAS) at 3 weeks after the last psilocybin session, compared to baseline. Improvement on the Subjective Emotional Health Visual Analogue Scale (SEHVAS), as assessed, Remission of depressive symptoms (QIDS-SR ≤5, MADRS ≤6) and improvement on the STAI, WHOQOL-BREF and M3VAS at 6 weeks and 12 weeks after the last psilocybin session, compared to baseline. Improvement on the SEHVAS, as assessed by the partner, at 12 weeks after the last psilocybin session, compared to baseline., Changes in brain activity as measured by EEG the day of the first integration session after each psilocybin session and at 12 weeks after the last psilocybin session, compared to baseline., Improvement on the Client Experiencing Scale (EXP) after each psilocybin session (during an integration session) as compared to before each psilocybin session (during a preparation session), independent of changes on the Working Alliance Inventory – Short Revised (WAI-12). Changes on the EXP are correlated to the Mystical Experience Questionnaire (MEQ) scores and depressive outcome., Improvement on the revised Dyadic Adjustment Scale (RDAS), for both the subject and the partner, at 3 weeks and 12 weeks after the last psilocybin session, compared to baseline. Improvement on the ZARIT-12 Burden scale (for the partner) at 3 weeks and 12 weeks after the last psilocybin session, compared to baseline., Interpretative Phenomenological Analysis (IPA) of semi-structured interviews with both subjects and their partners performed at the start of the trial, at 3 weeks after the last psilocybin session and (if they consent) at 1 year after the last psilocybin session., Descriptive analysis of the long-term evolution (mental state, occurrence of AEs, new therapies), assessed through monthly telephone calls and 2 (video) consultations (at 6 months and 1 year) up to one year after the last psilocybin session (if the subject consents). Evolution on the MADRS, WHOQOL-BREF and RDAS questionnaires, compared to baseline, at 6 months and 1 year after the last psilocybin session. Assessment of posttraumatic growth through PTGI-X 1 year after the last psilocybin session.

Source: https://euclinicaltrials.eu/ctis-public/view/2022-501857-35-00